EU clinical trial 2025-521256-29-00: A pharmacokinetic study of desmopressin - Minirin vs Sandoz
Sponsor: Region Midtjylland (Hospital/Clinic/Other health care facility). Phase: Therapeutic use (Phase IV). Countries: Denmark (authorised, recruitment pending).
Therapeutic area(s): Phenomena and Processes [G] - Reproductive and Urinary Physiological Phenomena [G08]
Gender: Female, Male. Age: 0-17 years. Enrolment: 24.
Status: Authorised, recruitment pending. Decision date: 2025-06-17. Results received: No. Last updated: 2026-01-05.

Condition(s): Nocturnal enuresis
Product: Desmopressin "Sandoz", sublinguale resoribletter, Minirin, frysetørrede tabletter

Primary endpoint: 1) Area under the curve (AUC) (power based on this endpoint).
Endpoint(s): 1) Plasmaconcentration (Cmax) 2) Time to maximum concentration (Tmax) 3) Urine osmolality (Uosm) 4) Urine output (uvol,ml 1) Taste 2) Textur 3) Preference

Source: https://euclinicaltrials.eu/ctis-public/view/2025-521256-29-00